EU clinical trial 2026-526078-18-00: A single center, randomized, controlled trial in healthy volunteers using dermal open flow microperfusion to assess cutaneous BE of two doxepin hydrochloride creams
Protocol code: FDA03A2
Sponsor: Medical University Of Graz (Educational Institution). Phase: Human Pharmacology (Phase I)- Bioequivalence Study. Countries: Austria (authorised, recruitment pending).
Therapeutic area(s): Not possible to specify
Gender: Female, Male. Age: 18-64 years, 65+ years. Enrolment: 24.
Status: Authorised, recruitment pending. Decision date: 2026-07-17. Results received: No. Last updated: 2026-07-17.

Condition(s): No medical condition is being investigated in this clinical trial.
Product: DOXEPIN HYDROCHLORIDE, DOXEPIN HYDROCHLORIDE

Primary endpoint: Pilot study: Dermal PK profiles (dOFM-measured concentration-time curves) for the target dose 1 and target dose 2., Pilot study: Dermal PK parameters (AUC(0 to 24)h, Cmax, tmax) for the target dose 1 and target dose 2., Pivotal BE study: Dermal PK profiles across subjects., Pivotal BE study: Dermal PK parameters AUC and Cmax of T and R and their descriptive statistics., Pivotal BE study: BE statistics: geometric mean ratios, variability estimates and confidence limits.

Source: https://euclinicaltrials.eu/ctis-public/view/2026-526078-18-00